EU clinical trial 2023-509741-12-00: A Phase 2, Multi-Center, Double-Blind, Placebo-Controlled Study to Evaluate the Safety, Efficacy, and Pharmacokinetics of Induction Therapy with PRA023 in Subjects with Moderately to Severely Active Ulcerative Colitis
Protocol code: PR200-102
Sponsor: Prometheus Biosciences Inc. (Pharmaceutical company). Phase: Therapeutic exploratory (Phase II). Countries: Czechia (ended), Poland (ended), France (ended), Hungary (ended).
Therapeutic area(s): Diseases [C] - Digestive System Diseases [C06]
Gender: Female, Male. Age: 18-64 years, 65+ years. Enrolment: 52.
Status: Ended. Start date (EU): 2021-09-23. End date (EU): 2025-07-15. End date: 2025-08-14. Decision date: 2024-10-04. Results received: Yes. Last updated: 2025-02-17.
Decision dates by country: CZ: 2024-10-08, FR: 2024-10-14, HU: 2024-10-04, PL: 2024-10-07

Condition(s): Ulcerative Colitis
Product: tulisokibart

Primary endpoint: The proportion of subjects reporting adverse events (AEs), serious adverse events (SAEs), AEs leading to discontinuation, and markedly abnormal laboratory values., The proportion of subjects in the 3-component Modified Mayo Score clinical remission (as defined by endoscopic subscore of 0 or 1, rectal bleeding subscore of 0, and stool frequency subscore of 0 or 1 and not greater than Baseline) at Week 12. The 3-component Modified Mayo Score ranges from 0-9 and includes rectal bleeding, stool frequency and endoscopic assessment domains.
Endpoint(s): • The proportion of subjects with endoscopic improvement, as defined by endoscopy subscore ≤ 1 with no friability, at Week 12., • The proportion of subjects in 3-component Modified Mayo Score clinical response at Week 12. The 3-component Modified Mayo Score clinical response is defined by reduction from Baseline ≥ 2 points and ≥ 30% in 3-component Modified Mayo Score, accompanied by a reduction ≥ 1 in rectal bleeding subscore or absolute rectal bleeding subscore ≤ 1., • The proportion of subjects in the 3-component Modified Mayo Score clinical remission (as defined by endoscopic subscore of 0 or 1, rectal bleeding subscore of 0, and stool frequency subscore of 0 or 1 and not greater than Baseline), in CDx+ subjects (Cohort 1 + Cohort 2) treated with PRA023 compared to CDx+ placebo-treated subjects at Week 12. The 3-component Modified Mayo Score ranges from 0-9 and includes rectal bleeding, stool frequency, and endoscopic assessment domains., • The proportion of subjects in symptomatic remission (as defined by rectal bleeding score = 0 and stool frequency score = 0) at Week 12., • The proportion of subjects with histologic remission (defined as Geboes score ≤ 3.1) at Week 12., • The proportion of subjects with histologic-endoscopic mucosal improvement (defined as Geboes score ≤ 3.1 and endoscopy subscore ≤ 1 with no friability) at Week 12., • The proportion of subjects with endoscopic improvement, as defined by endoscopy subscore ≤ 1 with no friability, in CDx+ subjects (Cohort 1 + Cohort 2) treated with PRA023 compared to CDx+ placebo-treated subjects at Week 12., • The proportion of subjects in 3-component Modified Mayo Score clinical response in CDx+ subjects treated with PRA023 compared to CDx+ placebo-treated subjects at Week 12. The 3-component Modified Mayo Score clinical response is defined by reduction from Baseline ≥ 2 points and ≥ 30% in 3-component Modified Mayo Score, accompanied by a reduction ≥ 1 in rectal bleeding subscore or absolute rectal bleeding subscore ≤ 1., • The proportion of subjects with symptomatic remission (as defined by rectal bleeding score = 0 and stool frequency score = 0) in CDx+ subjects (Cohort 1 + Cohort 2) treated with PRA023 compared to CDx+ placebo-treated subjects at Week 12., • The proportion of subjects with histologic remission, defined as Geboes score ≤ 3.1, in CDx+ subjects (Cohort 1 + Cohort 2) treated with PRA023 compared to CDx+ placebo-treated subjects at Week 12., • The proportion of subjects with histologic-endoscopic mucosal improvement (defined as Geboes score ≤ 3.1 and endoscopy subscore ≤ 1 with no friability), in CDx+ subjects (Cohort 1 + Cohort 2) treated with PRA023 compared to CDx+ placebo-treated subjects at Week 12., • The proportion of subjects with clinical remission (defined as endoscopic subscore of 0 or 1, rectal bleeding subscore of 0, and stool frequency subscore of 0 or 1 and not greater than Baseline) in CDx+ subjects (Cohort 1 + Cohort 2) treated with PRA023 compared to in CDx- subjects treated with PRA023 at Week 12., • The proportion of subjects with mucosal healing (defined as Geboes score ≤ 2B.1 and endoscopy subscore of ≤ 1) at Week 12., • The proportion of subjects with mucosal healing (defined as Geboes score ≤ 2B.1 and endoscopy subscore of ≤ 1), in CDx+ subjects (Cohort 1 + Cohort 2) treated with PRA023 compared to CDx+ placebo-treated subjects at Week 12., • The proportion of subjects with IBDQ response, as defined by ≥ 16-point increase from Baseline at Week 12., • The proportion of subjects with IBDQ response, as defined by ≥ 16-point increase from Baseline, in CDx+ subjects (Cohort 1 + Cohort 2) treated with PRA023 compared to CDx+ placebo-treated subjects at Week 12., • The proportion of subjects in the 3-component Modified Mayo Score clinical remission (as defined by endoscopic subscore of 0 or 1, rectal bleeding subscore of 0, and stool frequency subscore of 0 or 1 and not greater than Baseline), in CDx+ subjects treated with PRA023 compared to CDx+ placebo-treated subjects at Week 12.

Source: https://euclinicaltrials.eu/ctis-public/view/2023-509741-12-00